EU clinical trial 2023-503801-12-00: SLURP; A phase 2 intervention study: Detection of early esophageal neoplastic lesions by quantified fluorescence molecular endoscopy using oral and topical administration of bevacizumab-800CW and cetuximab-800CW
Protocol code: 16054
Sponsor: University Medical Center Groningen (Hospital/Clinic/Other health care facility). Phase: Therapeutic exploratory (Phase II). Countries: Netherlands (ended).
Therapeutic area(s): Diseases [C] - Digestive System Diseases [C06]; Diseases [C] - Neoplasms [C04]
Gender: Female, Male. Age: 18-64 years, 65+ years. Enrolment: 25.
Status: Ended. Start date (EU): 2023-09-15. End date (EU): 2026-05-07. Decision date: 2023-05-22. Results received: No. Last updated: 2024-02-08.

Condition(s): Barrett's esophagus
Product: Avastin 25 mg/ml concentrate for solution for infusion, Erbitux 5 mg/mL solution for infusion

Primary endpoint: Feasibility and safety of oral tracer administration, Evaluate combined tracer administration lead for increased lesion detection
Endpoint(s): Safety data on oral (combined) tracer administration, Quantify in vivo fluorescent signal and compare to ex vivo expression of VEGFA/EGFR, Specify and objectify the improvement of qFME and tracer administration

Source: https://euclinicaltrials.eu/ctis-public/view/2023-503801-12-00